EU clinical trial 2024-513313-13-00: A Phase 1/2A, Open Label Dose Escalation and Cohort Expansion Study of Orally Administered CA-4948 (IRAK4i) as a Monotherapy in Patients With Acute Myelogenous Leukemia or Myelodysplastic Syndrome
Protocol code: CA-4948-102
Sponsor: Curis Inc. (Pharmaceutical company). Phase: Phase I and Phase II (Integrated)- Other. Countries: Germany (ended), Spain (ended), France (ended).
Therapeutic area(s): Diseases [C] - Neoplasms [C04]
Gender: Female, Male. Age: 18-64 years, 65+ years. Enrolment: 70.
Status: Ended. Start date (EU): 2020-12-09. End date (EU): 2025-02-26. End date: 2026-03-24. Decision date: 2024-09-04. Results received: No. Last updated: 2024-09-30.
Decision dates by country: FR: 2024-09-30, DE: 2024-09-06, ES: 2024-09-04

Condition(s): Acute Myelogenous Leukemia (AML) or higher-risk Myelodysplastic Syndrome (MDS).
Product: CA-4948

Primary endpoint: Phase 1: Safety measured by adverse events (AEs), dose-limiting toxicities (DLTs) electrocardiograms (ECGs), chemistry and hematology laboratory values, vital signs, and physical examinations, Phase 2a: Clinical response in AML or hrMDS assessed as follows: • AML: Proportion of patients who achieve CR + CRh • hrMDS: ORR (CR + PR)
Endpoint(s): Phase 1: PK parameters of CA 4948 measured by maximum plasma concentration (Cmax), trough plasma concentration (Cmin), time to Cmax (Tmax,) area under the concentration-time curve from 0-24 hours (AUC 0-24), area under the concentration-time curve from 0 to infinity (AUC 0-inf), and half-life (T ½), Phase 1: Clinical response in AML :- Proportion of patients who achieve complete response (CR) + complete response with partial hematological recovery (CRh) - Proportion of patients who achieve complete response with incomplete hematological recovery (CRi), or CR, or CRh, or partial response (PR), or morphologic leukemia-free state (MLFS) - Duration of response (DOR) - Time to response, Phase 1: Clinical response in hrMDS: - Overall response rate (ORR): proportion of patients who achieve CR or PR - DOR - Time to response, Phase I: Transfusion independence in AML or hrMDS, Phase 2a: Safety measured by AEs, ECGs, chemistry and hematology laboratory values, vital signs, and physical examinations, Phase 2a: Clinical response in AML or hrMDS assessed as follows:- Proportion of patients with AML who achieve CR, or CRh, or CRi - Proportion of patients with hrMDS who achieve CR, or PR, or mCR, with or without hematological improvement - DOR - Time to responses - Transfusion independence - Overall survival (OS)

Source: https://euclinicaltrials.eu/ctis-public/view/2024-513313-13-00